EU clinical trial 2024-516808-42-00: Phase-II randomized clinical trial to evaluate the effect of Loratadine associated with Rapamune on Lymphagioleiomyomatosis (LAM).
Sponsor: Fundacio Institut D'Investigacio Biomedica De Bellvitge IDIBELL (Laboratory/Research/Testing facility). Phase: Therapeutic exploratory (Phase II). Countries: Spain (ended).
Therapeutic area(s): Diseases [C] - Respiratory Tract Diseases [C08]
Gender: Female. Age: 18-64 years, 65+ years. Enrolment: 62.
Status: Ended. Start date (EU): 2022-08-18. End date (EU): 2024-11-29. Decision date: 2024-09-19. Results received: Yes. Last updated: 2024-09-19.

Condition(s): Effect of loratadine in patients with lymphangioleiomyomatosis
Product: Loratadina NORMON 10 mg Comprimidos EFG

Primary endpoint: Incidence of adverse effects associated with taking loratadine associated with rapamycin, including nausea, diarrhea, abdominal pain, vomiting, headache, hypertransaminasemia.
Endpoint(s): - Maintenance of clinical stability (FEV1 drop < 10% or DLCO < 15%), - Decrease in the number of hospitalizations for any cause and respiratory causes, - Lung transplant, - Death.

Source: https://euclinicaltrials.eu/ctis-public/view/2024-516808-42-00